EU clinical trial 2025-521771-31-00: Pilot Study on Subcutaneously Administered Immunotherapy for the Treatment of Cervical Cancer
Protocol code: UMCG-NEOLYNC-001
Sponsor: Universitair Medisch Centrum Groningen (Hospital/Clinic/Other health care facility). Phase: Human Pharmacology (Phase I)- Other. Countries: Netherlands (ongoing, recruiting).
Therapeutic area(s): Diseases [C] - Female Urogenital Diseases and Pregnancy Complications [C13]; Diseases [C] - Neoplasms [C04]
Gender: Female. Age: 18-64 years, 65+ years. Enrolment: 12.
Status: Ongoing, recruiting. Start date (EU): 2026-01-05. Decision date: 2025-08-19. Results received: No. Last updated: 2025-08-19.

Condition(s): Cervical Cancer

Source: https://euclinicaltrials.eu/ctis-public/view/2025-521771-31-00